EU clinical trial 2024-519412-13-00: Phase 1/2, Open Label, Sequential Cohort Study of a Single Intracranial Dose of rAAVOlig001-ASPA Gene Therapy for Treatment of Children with Typical Canavan Disease
Protocol code: CD Olig001-101
Sponsor: Myrtelle Inc. (Pharmaceutical company). Phase: Phase I and Phase II (Integrated)- First administration to humans. Countries: France (authorised, recruitment pending).
Therapeutic area(s): Diseases [C] - Congenital, Hereditary, and Neonatal Diseases and Abnormalities [C16]
Gender: Female, Male. Age: 0-17 years. Enrolment: 7.
Status: Authorised, recruitment pending. Decision date: 2026-02-18. Results received: No. Last updated: 2026-06-12.

Condition(s): Canavan Disease, Canavan disease
Product: rAAV-Olig001-ASPA

Primary endpoint: Change from baseline to Month 6 in CSF NAA concentrations, as measured by biochemical assay.
Endpoint(s): Rate of change in myelin volume in the brain as measured by SyMRI through Month 12., Rate of change from baseline in Gross Motor Function Measure-88 total score, comparing FIH gene therapy–treated cohort to an external natural history cohort., Rate of change from baseline in Gross Motor Function Measure-88 specific domains, comparing FIH gene therapy–treated cohort to an external natural history cohort: - Lying/rolling domain - Sitting domain - Crawling domain - Standing domain - Walking domain, Rate of change from baseline in multivariate MSEL domains age-equivalent scores compared with an external natural history cohort. MSEL domains include: Visual Reception, Fine Motor, Receptive Language, Expressive Language, Gross Motor, Rate of change from baseline in univariate MSEL domains age-equivalent scores compared with an external natural history cohort: - MSEL Receptive Language domain - MSEL Expressive Language domain - MSEL Visual Reception domain - MSEL Fine Motor domain - MSEL - Gross Motor domain, Change from baseline to Month 6 in urine NAA concentrations, as measured by biochemical assays

Source: https://euclinicaltrials.eu/ctis-public/view/2024-519412-13-00